EU clinical trial 2025-523108-59-00: A Phase I study to evaluate the Safety, Tolerability, and Pharmacokinetics of BAL2420 in Healthy Adult Subjects
Protocol code: BAL2420-CP-101
Sponsor: Basilea Pharmaceutica International AG Allschwil (Pharmaceutical company). Phase: Human Pharmacology (Phase I)- First administration to humans. Countries: Netherlands (ongoing, recruiting).
Therapeutic area(s): Diseases [C] - Bacterial Infections and Mycoses [C01]
Gender: Female, Male. Age: 18-64 years. Enrolment: 136.
Status: Ongoing, recruiting. Start date (EU): 2026-03-04. Decision date: 2026-02-06. Results received: No. Last updated: 2026-07-29.

Condition(s): Severe infections caused by Gram-negative bacteria

Source: https://euclinicaltrials.eu/ctis-public/view/2025-523108-59-00